EU clinical trial 2024-520302-19-00: A Randomized, Double-Blinded, Placebo-Controlled Study to Evaluate the Efficacy and Safety of ATI-045 in Patients with Moderate-to-Severe Atopic Dermatitis
Protocol code: ATI-045-AD-201
Sponsor: Aclaris Therapeutics Inc. (Pharmaceutical company). Phase: Therapeutic exploratory (Phase II). Countries: Poland (not authorised), Czechia (not authorised), Germany (not authorised).
Therapeutic area(s): Diseases [C] - Skin and Connective Tissue Diseases [C17]
Gender: Female, Male. Age: 18-64 years, 65+ years. Enrolment: 54.
Status: Not authorised. Decision date: 2025-09-02. Results received: No. Last updated: 2025-09-08.
Decision dates by country: CZ: 2025-09-08, DE: 2025-09-02, PL: 2025-09-08

Condition(s): Atopic dermatitis
Product: ATI-045, Placebo to ATI-045

Primary endpoint: 1. Percent change from baseline in EASI score at Week 24
Endpoint(s): 1. Proportion of patients with validated Investigator Global Assessment (vIGA) treatment success (IGA-TS) (defined as score 0/1 and a reduction ≥2 points from baseline), at Week 24, 2. Proportion of patients with EASI reduction of 75% (EASI75) relative to baseline score at Week 24, 3. Change and percent change from baseline in weekly average of the daily Peak Pruritus Numerical Rating Scale (PP-NRS) score at Week 24, 4. Proportion of patients with a 4-point improvement or greater from baseline in weekly average of the daily Peak Pruritus Numerical Rating Scale (PP-NRS) at Week 24, 5. Proportion of patients with EASI reduction of 50% (EASI50) relative to baseline score at Week 24, 6. Proportion of patients with EASI reduction of 90% (EASI90) relative to baseline score at Week 24, 7. Change from baseline in body surface area (BSA) at Week 24, 8. Incidence and severity of treatment-emergent adverse events (TEAEs) and serious adverse events (SAEs) after first study drug dose on W0D1 until patient’s last visit., 9. Abnormality of clinical laboratory evaluations, 12-lead ECGs, vital signs, 10. Anti-ATI-045 antidrug antibody (ADA)

Source: https://euclinicaltrials.eu/ctis-public/view/2024-520302-19-00